EU clinical trial 2024-519051-28-01: NT-proBNP Selected PreventiOn of cardiac eveNts in a populaTion of dIabetic patients without A history of Cardiac disease; a prospective randomized trial
Sponsor: Medical University Of Vienna (Educational Institution). Phase: Therapeutic use (Phase IV). Countries: Spain (ended), Austria (ended).
Therapeutic area(s): Diseases [C] - Nutritional and Metabolic Diseases [C18]; Diseases [C] - Cardiovascular Diseases [C14]
Gender: Female, Male. Age: 18-64 years, 65+ years. Enrolment: 448.
Status: Ended. End date (EU): 2026-06-19. Decision date: 2025-02-14. Results received: No. Last updated: 2025-02-17.
Decision dates by country: AT: 2025-02-17, ES: 2025-02-14

Condition(s): Diabetes mellitus Type 2
Product: EPROSARTAN, ZOFENOPRIL, QUINAPRIL, RAMIPRIL, FOSINOPRIL, CARVEDILOL, NEBIVOLOL, CILAZAPRIL, VALSARTAN, LOSARTAN, METOPROLOL, BISOPROLOL, CANDESARTAN, ENALAPRIL, LISINOPRIL, IRBESARTAN, SPIRAPRIL, CAPTOPRIL, PERINDOPRIL

Primary endpoint: Combined endpoint based on the first occurrence of cardiac death and cardiac hospitalization.
Endpoint(s): All cardiac hospitalization, Heart failure hospitalization, All cause hospitalization, NT-proBNP, Other predefined (see section plasma and serum biomarkers) biomarkers, Health economic analysis (cost-effectiveness of intervention considering both life- years and quality of life adjusted life years)

Source: https://euclinicaltrials.eu/ctis-public/view/2024-519051-28-01